EU clinical trial 2025-520981-23-00: A Phase 2, Randomized, Parallel-Group, Double-Blind, Dose-Range-Finding Study to Evaluate the Safety and Efficacy of ALKS 2680 in Subjects With Idiopathic Hypersomnia
Protocol code: ALKS 2680-203
Sponsor: Alkermes Inc. (Pharmaceutical company). Phase: Therapeutic exploratory (Phase II). Countries: Italy (ongoing, recruiting), Belgium (ongoing, recruiting), Czechia (ongoing, recruiting), France (ongoing, recruiting), Netherlands (ended), Spain (ongoing, recruiting).
Therapeutic area(s): Diseases [C] - Nervous System Diseases [C10]
Gender: Female, Male. Age: 18-64 years, 65+ years. Enrolment: 55.
Start date (EU): 2025-08-26. Decision date: 2025-08-19. Results received: No. Last updated: 2026-08-06.
Decision dates by country: NL: 2025-08-25, CZ: 2025-08-19, IT: 2025-08-21, BE: 2025-08-21, FR: 2025-08-22, ES: 2025-08-20

Condition(s): Idiopathic Hypersomnia (IH)
Product: ALKS 2680, Placebo to match ALKS 2680, ALKS 2680, ALKS 2680

Primary endpoint: Change in Epworth Sleepiness Scale (ESS) from baseline to Week 8 by dose level.
Endpoint(s): Change in Idiopathic Hypersomnia Severity Scale (IHSS) from baseline to Week 8 by dose level., • TEAEs • Clinical laboratory assessments • Vital signs • Safety ECG • C-SSRS

Source: https://euclinicaltrials.eu/ctis-public/view/2025-520981-23-00